EU clinical trial 2023-506284-34-00: Pharmacokinetics, safety, and efficacy of fisetin - A phase I and pilot phase IIa study
Sponsor: Hvidovre Hospital (Hospital/Clinic/Other health care facility). Phase: Phase I and Phase II (Integrated)- Other. Countries: Denmark (ongoing, recruiting).
Therapeutic area(s): Phenomena and Processes [G] - Immune System Phenomena [G13]; Phenomena and Processes [G] - Cell Physiological Phenomena [G04]; Phenomena and Processes [G] - Immune system processes [G12]
Gender: Female, Male. Age: 18-64 years, 65+ years. Enrolment: 60.
Status: Ongoing, recruiting. Start date (EU): 2026-03-24. Decision date: 2024-03-26. Results received: No. Last updated: 2025-07-04.

Condition(s): Healthy, Multimorbidity

Source: https://euclinicaltrials.eu/ctis-public/view/2023-506284-34-00